EU clinical trial 2022-500574-34-00: Efficacy of Venetoclax in combination with Rituximab in Waldenström’s Macroglobulinemia
Protocol code: VIWA-1
Sponsor: University Hospital Of Ulm AöR (Hospital/Clinic/Other health care facility). Phase: Therapeutic exploratory (Phase II). Countries: Germany (ongoing, recruiting), Greece (ongoing, recruiting).
Therapeutic area(s): Diseases [C] - Neoplasms [C04]; Diseases [C] - Hemic and Lymphatic Diseases [C15]
Gender: Female, Male. Age: 18-64 years, 65+ years. Enrolment: 55.
Status: Ongoing, recruiting. Start date (EU): 2025-03-21. Decision date: 2024-11-19. Results received: No. Last updated: 2026-03-18.
Decision dates by country: GR: 2024-11-20, DE: 2024-11-19

Condition(s): Waldenström’s Macroglobulinemia
Product: DEXAMETHASONE, Ruxience 500 mg concentrate for solution for infusion, Venetoclax, RITUXIMAB, CYCLOPHOSPHAMIDE

Primary endpoint: Rate of complete remission (CR) or very good partial remission (VGPR) 12 months after randomization using the modified response criteria updated at the Sixth IWWM (CR/VGPR).
Endpoint(s): Interim Response (C4D1; C7D1 (arm A) / 28 days after C6D1 (arm B); C10D1 (arm A) / post treatment staging 1 (arm B), Response and response rate: Overall response rate (CR, VGPR, PR, MR) 12 months after randomization; Major Response rate (CR, VGPR, PR) 12 months from randomization, Best response from randomization up to 24 months, Time to first overall response within 24 months from start of treatment, Time to first major response within 24 months from start of treatment, Event free survival (EFS), Response duration (RD), Progression free survival (PFS), Lymphoma specific survival (LSS), Overall survival (OS), Safety, Quality of life, Comparison of response rates between CXCR4 mutated and CXCR4 wildtype patients

Source: https://euclinicaltrials.eu/ctis-public/view/2022-500574-34-00